EU clinical trial 2024-517190-24-00: CATALINA-2: A Phase 2 Study Evaluating the Efficacy and Safety of TORL-1-23 in Women With Advanced Platinum-Resistant Epithelial Ovarian Cancer (Including Primary Peritoneal and Fallopian Tube Cancers) Expressing Claudin 6 (CLDN6)
Protocol code: TORL123-002
Sponsor: Torl Biotherapeutics LLC (Pharmaceutical company). Phase: Therapeutic exploratory (Phase II). Countries: Ireland (temporarily halted), Belgium (temporarily halted), Austria (temporarily halted), France (temporarily halted), Germany (temporarily halted), Spain (temporarily halted), Czechia (temporarily halted), Italy (temporarily halted).
Therapeutic area(s): Diseases [C] - Neoplasms [C04]
Gender: Female. Age: 18-64 years, 65+ years. Enrolment: 159.
Status: Temporarily halted. Start date (EU): 2025-09-16. Decision date: 2025-07-07. Results received: No. Last updated: 2026-05-11.
Decision dates by country: AT: 2025-07-14, FR: 2025-07-15, DE: 2025-07-10, BE: 2025-07-07, IT: 2025-07-10, IE: 2025-07-11, ES: 2025-07-09, CZ: 2025-07-08

Condition(s): Peritoneal Cancer, Ovarian Cancer, Fallopian Tube Cancer
Product: PEGFILGRASTIM, TORL-1-23

Primary endpoint: Objective Response Rate (ORR) per Response Evaluation Criteria in Solid Tumors (RECIST) version 1.1 (as defined by confirmed best overall response of partial or complete responses) by blinded independent central review (BICR).

Source: https://euclinicaltrials.eu/ctis-public/view/2024-517190-24-00